EU clinical trial 2024-514514-12-00: Study on the investigational drug SAN711, placebo-controlled, administered to healthy adults and elderly subjects at multiple ascending oral doses to evaluate the safety, tolerability, pharmacokinetics, pharmacodynamics of SAN711 and its interaction with food
Protocol code: SAN711-002
Sponsor: Saniona A/S (Pharmaceutical company). Phase: Human Pharmacology (Phase I)- Other. Countries: Italy (ended).
Therapeutic area(s): Diseases [C] - Nervous System Diseases [C10]
Gender: Female, Male. Age: 18-64 years, 65+ years. Enrolment: 50.
Status: Ended. Start date (EU): 2025-02-12. End date (EU): 2025-11-15. Decision date: 2024-09-16. Results received: No. Last updated: 2025-07-08.

Condition(s): Absence Seizure, Essential tremor

Source: https://euclinicaltrials.eu/ctis-public/view/2024-514514-12-00